EU clinical trial 2024-516240-26-00: A Phase 3, Randomized, Observer-blind, Active-controlled, Case-driven Study to Investigate the Safety, Efficacy, and Immunogenicity of mRNA-1010 Candidate Seasonal Influenza Vaccine Compared with a Licensed Inactivated Seasonal Influenza Vaccine in Adults ≥50 Years of Age
Protocol code: mRNA-1010-P304
Sponsor: Moderna Inc. (Pharmaceutical company). Phase: Therapeutic confirmatory (Phase III). Countries: Germany (ended), Bulgaria (ended), Estonia (ended), Finland (ended), Belgium (ended).
Therapeutic area(s): Diseases [C] - Virus Diseases [C02]
Gender: Female, Male. Age: 18-64 years, 65+ years. Enrolment: 15490.
Status: Ended. Start date (EU): 2024-10-11. End date (EU): 2025-07-04. End date: 2025-08-21. Decision date: 2024-09-06. Results received: Yes. Last updated: 2025-05-21.
Decision dates by country: EE: 2024-10-14, DE: 2024-09-06, FI: 2024-10-29, BG: 2024-09-11, BE: 2024-10-17

Condition(s): Influenza
Product: Influsplit Tetra 2024/2025 Injektionssuspension in Fertigspritze Influenza-Spaltimpfstoff (inaktiviert)

Primary endpoint: Number of Participants with Solicited Local and Systemic Adverse Reactions (ARs) from day 1 to day 7, Number of Participants with Unsolicited Adverse Events (AEs) from day 1 to day 28, Number of Participants with Medically Attended AEs (MAAEs), AEs Leading to Discontinuation, Serious Adverse Events (SAEs), or Adverse Events of Special Interest (AESI) from day 1 to day 181, Time to First Episode of Reverse Transcriptase-Polymerase Chain Reaction (RT-PCR) Confirmed Protocol Defined ILI (ILI caused by any influenza A or B strain from day 14 up to End of Season (up to approximately day 181)
Endpoint(s): Number of Participants with First Episode of RT-PCR Confirmed Modified US Centers for Disease Control and Prevention (CDC)-Defined ILI (ILI caused by any influenza A or B strains) from Day 14 up to End of Season (up to approximately Day 181), Number of Participants with First Episode of RT-PCR Confirmed Protocol-Defined ILI or Modified CDC-Defined ILI (ILI caused by influenza A or B strains with antigenic match to the vaccine strains) from Day 14 up to End of Season (up to approximately Day 181), Geometric Mean Titer (GMT) of Hemagglutination Inhibition (HAI) (Humoral immunogenicity) at day 29, Number of Participants Reaching Seroconversion as Measured by HAI at Day 29, Number of Participants with an HAI Titer ≥1:40 at Day 29, Geometric Mean Fold Rise (GMFR) of HAI Titers at Day 1 and Day 29, HAI Titer (As measured by the HAI Assay) at Day 29, Number of Participants with First Episode of RT-PCR-Confirmed Protocol-Defined ILI (Correlates of Risk (CoR) and Correlates of Protection (CoP)) from Day 14 up to End of Season (up to approximately Day 181)

Source: https://euclinicaltrials.eu/ctis-public/view/2024-516240-26-00